EU clinical trial 2024-519180-17-00: A PHASE 1 STUDY WITH SINGLE ASCENDING DOSE, MULTIPLE ASCENDING DOSE AND FOOD EFFECT OF LMT503 IN HEALTHY SUBJECTS.
Protocol code: LMT503-101
Sponsor: Lmito Therapeutics Inc. (Pharmaceutical company). Phase: Human Pharmacology (Phase I)- First administration to humans. Countries: Netherlands (authorised, recruitment pending).
Therapeutic area(s): Diseases [C] - Digestive System Diseases [C06]
Gender: Female, Male. Age: 18-64 years. Enrolment: 72.
Status: Authorised, recruitment pending. Decision date: 2024-11-25. Results received: No. Last updated: 2024-11-25.

Condition(s): Healthy volonteers

Source: https://euclinicaltrials.eu/ctis-public/view/2024-519180-17-00